EU clinical trial 2024-512554-15-00: A Phase I/III Randomized, Double-blind Study to Evaluate the Safety, Efficacy, and Neutralizing Activity of AZD5156/AZD3152 for Pre-exposure Prophylaxis of COVID-19 in Participants with Conditions Causing Immune Impairment
Protocol code: D7000C00001
Sponsor: AstraZeneca AB (Pharmaceutical company). Phase: Therapeutic confirmatory (Phase III). Countries: Spain (ended), France (ended), Germany (ended), Poland (ended), Belgium (ended), Denmark (ended).
Therapeutic area(s): Diseases [C] - Respiratory Tract Diseases [C08]
Gender: Female, Male. Age: 0-17 years, 18-64 years, 65+ years. Enrolment: 533.
Status: Ended. Start date (EU): 2023-06-21. End date (EU): 2025-02-07. End date: 2025-02-11. Decision date: 2024-07-11. Results received: Yes. Last updated: 2025-02-28.
Decision dates by country: DK: 2024-07-12, DE: 2024-07-12, ES: 2024-07-12, PL: 2024-08-04, FR: 2024-07-12, BE: 2024-07-11

Condition(s): COVID-19
Product: Sipavibart, SODIUM CHLORIDE, EVUSHELD 150 mg + 150 mg solution for injection, EVUSHELD 150 mg + 150 mg solution for injection

Primary endpoint: Main Cohort: Occurrence of AEs collected through approximately 90 days after each IMP administration SAEs, MAAEs and AESIs collected through the study, Main Cohort: Population: SARS-CoV-2-Negative Set Endpoint: Confirmed symptomatic COVID-19 case, classified as a binary outcome incorporating the time from the first dose of IMP until a participant develops their first symptoms for COVID-19. Summary measure: Prophylactic efficacy, calculated as 1-HR (AZD3152 versus EVUSHELD and/or placebo) using a hazard regression model., Main Cohort: Population: SARS-CoV-2-Negative Set Endpoint: Confirmed symptomatic COVID-19 case attributable to matched variants, classified as a binary outcome incorporating the time from the first dose of IMP until a participant develops their first symptoms for COVID-19. Summary measure: Prophylactic efficacy, calculated as 1-HR (AZD3152 versus EVUSHELD and/or placebo) using a hazard regression model., Sentinel Safety Cohort: Occurrence of AEs collected through approximately 90 days after IMP administration; SAEs, MAAEs, and AESIs collected through the study.
Endpoint(s): Main Cohort: Geometric mean titer (GMT) and geometric mean fold rise (GMFR) ratio of SARS-CoV-2 nAbs between the treatment arms at Visit 3 (Day 29)., Main Cohort: Incidence of a post treatment: - Symptomatic COVID-19 case caused by any SARS-CoV-2 variant; - Symptomatic COVID-19 case caused by any SARS-CoV-2 matched variants •Severe COVID-19 caused by any SARS-CoV-2 variant; • Severe COVID-19 caused by any SARS-CoV-2 matched variants; •Composite of COVID-19 related hospitalization and/or COVID-19 related death; •COVID-19 related hospitalization (separately); •COVID-19 related death (separately)., Main Cohort: AZD3152, AZD7442, AZD1061 and AZD8895 concentrations over time and PK parameters., Main Cohort: Incidence of ADA to AZD3152, AZD7442, AZD1061, and AZD8895, ADA titers., Sentinel Safety Cohort: AZD5156, AZD1061, and AZD3152 concentrations over time and PK parameters., Sentinel Safety Cohort: Incidence of ADA.

Source: https://euclinicaltrials.eu/ctis-public/view/2024-512554-15-00